EU clinical trial 2024-510569-41-00: The effects of various concentrations of ropivacaine on the onset and duration of ultrasound-guided ankle blocks in patients undergoing hallux valgus repair surgery – a randomized, double-blinded, parallel-group interventional study
Sponsor: Ziekenhuis Oost Limburg (Hospital/Clinic/Other health care facility). Phase: Therapeutic use (Phase IV). Countries: Belgium (ongoing, recruiting).
Therapeutic area(s): Health Care [N] - Health Care Quality, Access, and Evaluation [N05]
Gender: Female, Male. Age: 18-64 years, 65+ years. Enrolment: 174.
Status: Ongoing, recruiting. Start date (EU): 2025-05-22. Decision date: 2024-04-26. Results received: No. Last updated: 2026-03-18.

Condition(s): Hallux valgus
Product: ROPIVACAINE

Primary endpoint: The primary endpoint is the difference in the duration of the sensory blocks.
Endpoint(s): The difference in onset time of the sensory block., The difference in motor function., The difference in postoperative pain scores (analgesia)., The difference in opioid consumption.

Source: https://euclinicaltrials.eu/ctis-public/view/2024-510569-41-00